EU clinical trial 2024-518301-18-00: Phase 1 trial of trametinib and gilteritinib for the treatment of relapsed or refractory acute leukemia patients
Protocol code: IHT-001
Sponsor: Instytut Hematologii I Transfuzjologii (Laboratory/Research/Testing facility). Phase: Human Pharmacology (Phase I)- Other. Countries: Poland (ongoing, recruiting).
Therapeutic area(s): Diseases [C] - Hemic and Lymphatic Diseases [C15]
Gender: Female, Male. Age: 18-64 years, 65+ years. Enrolment: 54.
Status: Ongoing, recruiting. Start date (EU): 2022-01-28. Decision date: 2024-12-16. Results received: No. Last updated: 2025-12-18.

Condition(s): Relapsed and/or refractory acute lymphoblastic (ALL) or myeloid (AML) leukemia in patients who are not eligible for curative therapies and lack other available therapeutic options

Source: https://euclinicaltrials.eu/ctis-public/view/2024-518301-18-00